EU clinical trial 2025-524999-37-00: A study comparing different dosage forms of midazolam and how they are taken up in the body.
Protocol code: 038-2025-BA-MDZ
Sponsor: MIDAS Pharma GmbH (Pharmaceutical company). Phase: Human Pharmacology (Phase I)- Other. Countries: Czechia (authorised, recruitment pending).
Therapeutic area(s): Analytical, Diagnostic and Therapeutic Techniques and Equipment [E] - Anesthesia and Analgesia [E03]
Gender: Male. Age: 18-64 years. Enrolment: 16.
Status: Authorised, recruitment pending. Decision date: 2026-05-26. Results received: No. Last updated: 2026-05-26.

Condition(s): Bioavailability Study under Fasting Conditions

Source: https://euclinicaltrials.eu/ctis-public/view/2025-524999-37-00